EU clinical trial 2024-515654-25-00: A Phase Ib/II Study of APG-2575 as a Single Agent or in Combination with Other Therapeutic Agents in Patients with Relapsed and/or Refractory Chronic Lymphocytic Leukemia (CLL)/Small Lymphocytic Lymphoma (SLL) (SACRED).
Protocol code: APG-2575CU101
Sponsor: Ascentage Pharma Group Inc. (Pharmaceutical company). Phase: Phase I and Phase II (Integrated)- Other. Countries: Hungary (authorised, recruiting), Poland (ended).
Therapeutic area(s): Diseases [C] - Hemic and Lymphatic Diseases [C15]
Gender: Female, Male. Age: 18-64 years, 65+ years. Enrolment: 60.
Start date (EU): 2021-12-20. Decision date: 2024-09-17. Results received: No. Last updated: 2026-04-22.
Decision dates by country: PL: 2024-10-28, HU: 2024-09-17

Condition(s): Relapsed and/or Refractory Chronic Lymphocytic Leukemia (CLL)/Small Lymphocytic Lymphoma (SLL).
Product: Calquence 100 mg hard capsules, IMBRUVICA 420 mg film-coated tablets, IMBRUVICA 140 mg hard capsules, IMBRUVICA 140 mg hard capsules, BRUKINSA 80 mg hard capsules, Lisaftoclax, Calquence 100 mg hard capsules, MabThera 500 mg concentrate for solution for infusion, Lisaftoclax, Lisaftoclax

Primary endpoint: Primary endpoints include characterizing safety and tolerability, defining the MTD and recommended phase 2 dose (RP2D).
Endpoint(s): Secondary endpoints include determining the effectiveness of APG-2575 as monotherapy and in combination with other anticancer agents in patients with relapsed and/or refractory CLL by determining ORR (CR and PR) and MRD negativity.

Source: https://euclinicaltrials.eu/ctis-public/view/2024-515654-25-00